EU clinical trial 2023-506127-29-00: J2P-MC-LXBD: A Phase 2, Randomized, Double-Blind, Placebo Controlled, Dose-Ranging Study to Evaluate LY3556050 in Adult Participants With Diabetic Peripheral Neuropathic Pain
Protocol code: J2P-MC-LXBD
Sponsor: Eli Lilly & Co. (Pharmaceutical company). Phase: Therapeutic exploratory (Phase II). Countries: Poland (ended), Czechia (ended).
Therapeutic area(s): Diseases [C] - Nervous System Diseases [C10]
Gender: Female, Male. Age: 18-64 years, 65+ years. Enrolment: 146.
Start date (EU): 2024-03-05. End date: 2025-06-12. Decision date: 2024-02-19. Results received: Yes. Last updated: 2025-12-11.
Decision dates by country: PL: 2024-02-19, CZ: 2024-05-20

Condition(s): Diabetic Peripheral Neuropathy
Product: Placebo to match LY3556050

Primary endpoint: Mean Change from Baseline for Average Pain Intensity Numeric Rating Scale (API-NRS)

Source: https://euclinicaltrials.eu/ctis-public/view/2023-506127-29-00